EU clinical trial 2025-523847-36-00: A Single-Dose Pharmacokinetic Study of Eloralintide in Participants with Varying Degrees of Liver Impairment and Participants with Normal Liver Function
Protocol code: J3R-MC-YDAH
Sponsor: Eli Lilly & Co. (Pharmaceutical company). Phase: Human Pharmacology (Phase I)- Other. Countries: Hungary (ongoing, recruiting).
Therapeutic area(s): Diseases [C] - Digestive System Diseases [C06]; Diseases [C] - Nutritional and Metabolic Diseases [C18]
Gender: Female, Male. Age: 18-64 years, 65+ years. Enrolment: 12.
Status: Ongoing, recruiting. Start date (EU): 2026-05-19. Decision date: 2026-04-14. Results received: No. Last updated: 2026-04-14.

Condition(s): Participants with Mild, Moderate, or Severe Hepatic Impairment and Participants with Normal Hepatic Function

Source: https://euclinicaltrials.eu/ctis-public/view/2025-523847-36-00